EU clinical trial 2024-518522-32-00: Efficacy of Olaparib in advanced cancers occurring in patients with germline mutations or somatic tumor mutations in homologous recombination genes.A Belgian Precision 2 study
Protocol code: BSMO 1-2018
Sponsor: Belgian Society Of Medical Oncology (Hospital/Clinic/Other health care facility). Phase: Therapeutic exploratory (Phase II). Countries: Belgium (ended).
Therapeutic area(s): Diseases [C] - Pathological Conditions, Signs and Symptoms [C23]
Gender: Female, Male. Age: 18-64 years, 65+ years. Enrolment: 351.
Status: Ended. Start date (EU): 2019-02-07. End date (EU): 2025-10-31. Decision date: 2024-10-18. Results received: Yes. Last updated: 2024-10-18.

Condition(s): Basket tumors
Product: Lynparza 100 mg film-coated tablets, Lynparza 150 mg film-coated tablets

Primary endpoint: Response rate according to RECIST 1.1, Response duration
Endpoint(s): Correlate efficacy with locus-specific LOH in the tumors in case of cancers atypical for the germline mutations., PFS, OS, Safety by reporting all adverse events

Source: https://euclinicaltrials.eu/ctis-public/view/2024-518522-32-00